EU clinical trial 2024-512172-35-00: Impact of CHOlinergic Stimulation on COgnitive and MOtor Functions and Brain Activity in Elderly Volunteers (CHOCOMO) - a randomised, placebo-controlled trial
Protocol code: 2023-UOL-MG-004-01
Sponsor: Carl Von Ossietzky Universitaet Oldenburg (Educational Institution). Phase: Therapeutic exploratory (Phase II). Countries: Germany (ended).
Therapeutic area(s): Diseases [C] - Nervous System Diseases [C10]
Gender: Female, Male. Age: 18-64 years, 65+ years. Enrolment: 50.
Status: Ended. Start date (EU): 2025-02-17. End date (EU): 2026-07-29. Decision date: 2024-07-16. Results received: No. Last updated: 2025-03-12.

Condition(s): neurological disorders
Product: Donepezilhydrochlorid Heumann 5 mg Filmtabletten, Placebo to match Donepezil

Primary endpoint: Dual-task costs (DTC): calculated as the difference between the scores of the dual-task and single-task performances and measured as reaction time (ms) in the cognitive task and motor pedaling speed (ms) in the motor task after donepezil or placebo administration, respectively, at V1 and 2
Endpoint(s): Neuronal activity: measured after donepezil or placebo administration, respectively, by fMRI during task performance at visit 1 and 2, Relative cognitive and motor performances in other neuropsychological tests: 1. measured by reaction times (ms) and % correct responses in the sub-tests of TAP-M test battery and 2. measured by time (s) conducting the TUG-test variant, both after donepezil or placebo administration, respectively, at V1 and 2

Source: https://euclinicaltrials.eu/ctis-public/view/2024-512172-35-00